EU clinical trial 2024-520155-24-00: A Phase II, randomized, open-label, multi-center study of JSB462 in combination with lutetium (177Lu) vipivotide tetraxetan in adult male patients with PSMA-positive metastatic castration resistant prostate cancer (mCRPC)
Protocol code: CJSB462B12201
Sponsor: Novartis Pharma AG (Pharmaceutical company). Phase: Therapeutic exploratory (Phase II). Countries: Netherlands (ongoing, recruitment ended), Austria (ongoing, recruitment ended), Germany (ongoing, recruitment ended), Italy (ongoing, recruitment ended), France (ongoing, recruitment ended), Czechia (ongoing, recruitment ended), Spain (ongoing, recruitment ended).
Therapeutic area(s): Diseases [C] - Neoplasms [C04]
Gender: Male. Age: 18-64 years, 65+ years. Enrolment: 46.
Status: Ongoing, recruitment ended. Start date (EU): 2025-10-16. Decision date: 2025-09-17. Results received: No. Last updated: 2026-04-07.
Decision dates by country: AT: 2025-09-22, CZ: 2025-09-22, IT: 2025-09-19, FR: 2025-09-24, ES: 2025-09-22, DE: 2025-09-17, NL: 2025-09-18

Condition(s): Metastatic castration resistant prostate cancer (mCRPC)
Product: Luxdegalutamide, GOZETOTIDE, Pluvicto 1 000 MBq/mL solution for injection/infusion

Primary endpoint: Efficacy: PSA50 rate defined as the proportion of participants who achieve a ≥50% decrease in PSA from baseline at any timepoint, confirmed by a second PSA measurement ≥3 weeks without any PSA progression in between, Safety: Type, frequency and severity of AEs per Common Terminology Criteria for Adverse Events (CTCAE) version 5.0, and changes in laboratory values, vital signs, and ECGs., Tolerability: Dose interruptions, dose reductions, drug discontinuations, dose intensity, and duration of exposure to study treatment (all study drugs).
Endpoint(s): rPFS defined as time between randomization and the first occurrence of disease progression (per PCWG3-modified RECIST v1.1 as assessed by the investigator) or death due to any cause, OS defined as time between randomization and death due to any cause, • Type, frequency and severity of AEs and SAEs • Laboratory abnormalities as characterized by type, frequency, severity (as graded by NCI CTCAE version 5.0) and timing, Endpoints assessed per PCWG3-modified RECIST v1.1 by investigator’s assessment: • ORR - proportion of participants with complete response (CR) or partial response (PR); • DCR - proportion of participants with CR, PR or stable disease (SD); • DOR - time from CR/PR to disease progression or death; • TTR - time from randomization to CR or PR; • TTSTP - time from randomization to soft tissue progression., • PSA90 rate - proportion of participants with ≥90% decrease from baseline at any timepoint, confirmed by a second measurement ≥3 weeks; • PSA30 rate - proportion of participants with ≥30% decrease from baseline at any timepoint, confirmed by a second measurement ≥3 weeks; • PSA0 rate - proportion of participants with PSA <0.2 ng/ml at any timepoint, confirmed by a second measurement ≥3 weeks., Duration of biochemical response defined as time between PSA50 and PSA progression or death due to any cause, TTSSE defined as date of randomization to the date of first new symptomatic pathological bone fracture, spinal cord compression, tumor-related orthopedic surgical intervention, requirement for radiation therapy to relieve bone pain or death from any cause, whichever occurs first, Plasma concentrations of JSB462 and ARV-767 pre and post dose, Concentrations of AAA617 in blood over time and PK parameters from blood radioactivity data, Radiation absorbed doses in organs and tumors for AAA617, Frequency, severity, and/or interference of selected items as assessed using the PRO-CTCAE

Source: https://euclinicaltrials.eu/ctis-public/view/2024-520155-24-00